EU clinical trial 2025-521480-12-00: A Phase 1 Study of ATV-1601, in Patients with Advanced Cancer that have AKT1 E17K Mutations
Protocol code: ATV-1601-101
Sponsor: Atavistik Bio Inc. (Pharmaceutical company). Phase: Human Pharmacology (Phase I)- First administration to humans. Countries: Belgium (ended), Italy (ended), Spain (ended), France (ended).
Therapeutic area(s): Diseases [C] - Neoplasms [C04]
Gender: Female, Male. Age: 18-64 years, 65+ years. Enrolment: 64.
Status: Ended. Start date (EU): 2025-10-22. End date (EU): 2026-04-17. Decision date: 2025-09-15. Results received: No. Last updated: 2026-04-01.
Decision dates by country: BE: 2025-09-15, IT: 2025-09-22, FR: 2025-09-15, ES: 2025-09-25

Condition(s): Advanced solid tumors, Breast Cancer

Source: https://euclinicaltrials.eu/ctis-public/view/2025-521480-12-00